EU clinical trial 2023-508100-38-00: SAFIR ABC10 : Molecular targeted maintenance therapy versus standard of care in advanced biliary cancer: an international, randomised, controlled, open-label, platform phase 3 trial
Sponsor: Unicancer (Hospital/Clinic/Other health care facility). Phase: Therapeutic confirmatory (Phase III). Countries: France (ongoing, recruiting), Belgium (ongoing, recruiting).
Therapeutic area(s): Diseases [C] - Neoplasms [C04]
Gender: Female, Male. Age: 18-64 years, 65+ years. Enrolment: 700.
Status: Ongoing, recruiting. Start date (EU): 2024-06-24. Decision date: 2023-12-22. Results received: No. Last updated: 2026-06-08.
Decision dates by country: BE: 2024-10-09, FR: 2023-12-22

Condition(s): Advanced Biliary Cancer (ABC)
Product: Zercepac 150 mg powder for concentrate for solution for infusion., CISPLATIN, GEMCITABINE, Braftovi 75 mg hard capsules, IVOSIDENIB, Futibatinib, JZP598, Mektovi 15 mg film-coated tablets, PEMBROLIZUMAB, IMFINZI 50 mg/mL concentrate for solution for infusion., Nerlynx 40 mg film-coated tablets, Zejula 100 mg hard capsules

Primary endpoint: Progression-free survival defined as the time from randomisation to the first documented progression of disease (PD) as assessed by the investigator according to RECIST v1.1, or death from any cause, whichever occurs first. Patients alive and free of progression at the cut-off date will be censored at the last assessment date.
Endpoint(s): Overall Survival (OS), defined as the time from randomisation to death due to any cause. Patients alive at the cut-off date will be censored on the last date the patient was known to be alive or lost to follow-up or withdraw consent., Objective response rate, defined as the proportion of patients achieving CR or partial response (PR) as assessed by the investigator according to RECIST v1.1. Objective response rate will be presented as the best response achieved compared to the disease assessment performed at randomisation., Time to treatment failure, defined as the time from patient starting their allocated treatment to the date at which a patient first experiences a treatment failure event., Progression-free survival after next line of treatment (PFS2), defined as the time from randomisation to the date of second progression or death, whichever occurs first. Patients alive and free of second progression at the cut-off date will be censored at the last assessment date., Duration of response, defined as the time from first documented PR or CR (compared to baseline measurement taken at randomisation) until the date of PD, as assessed by the investigator according to RECIST v1.1, or death from any cause whichever occurs first. Patients who are alive and have not progressed at the time of the analysis will be censored at their last evaluable tumour assessment.

Source: https://euclinicaltrials.eu/ctis-public/view/2023-508100-38-00